EU clinical trial 2024-516085-11-00: Efficacy of Morphine in Reducing the Rate of Early Non-Invasive Ventilation Failure in Acute Exacerbation of Chronic Obstructive Pulmonary Disease, Phase I/IIa (MORPHEUS I/IIa)
Sponsor: Centre Hospitalier Universitaire Grenoble Alpes (Hospital/Clinic/Other health care facility). Phase: Phase I and Phase II (Integrated)- Other. Countries: France (authorised, recruitment pending).
Therapeutic area(s): Diseases [C] - Respiratory Tract Diseases [C08]
Gender: Female, Male. Age: 18-64 years, 65+ years. Enrolment: 24.
Status: Authorised, recruitment pending. Decision date: 2024-10-07. Results received: No. Last updated: 2026-06-26.

Condition(s): Chronic Obstructive Pulmonary Disease

Source: https://euclinicaltrials.eu/ctis-public/view/2024-516085-11-00